EU clinical trial 2024-518682-95-00: SIGNAL - Body fluid proteome SIGnatures for persoNALised intervention to prevent cardiovascular and renal complications in diabetes
Sponsor: Steno Diabetes Center Copenhagen (Hospital/Clinic/Other health care facility). Phase: Therapeutic use (Phase IV). Countries: Denmark (ongoing, recruiting), Spain (ongoing, recruiting).
Therapeutic area(s): Not possible to specify
Gender: Female, Male. Age: 18-64 years, 65+ years. Enrolment: 46.
Status: Ongoing, recruiting. Start date (EU): 2025-10-20. Decision date: 2025-02-09. Results received: No. Last updated: 2026-08-06.
Decision dates by country: ES: 2025-09-03, DK: 2025-02-09

Condition(s): Type 2 Diabetes
Product: DAPAGLIFLOZIN, SEMAGLUTIDE, DAPAGLIFLOZIN, SEMAGLUTIDE, SEMAGLUTIDE, FINERENONE, SEMAGLUTIDE, FINERENONE, SEMAGLUTIDE, SEMAGLUTIDE, SEMAGLUTIDE, SEMAGLUTIDE, SEMAGLUTIDE

Primary endpoint: Feasibility: • Achieve urine proteomic results within 2 weeks of sampling for at least 90% of the participants in clinical practice., Feasibility: • Ensure that urine proteomic results are interpreted for evaluating medical treatment in at least 90% of participants.
Endpoint(s): •Changes in UACR from screening visit to the end of study, •Changes in urinary proteomic signatures from screening visit to the end of study

Source: https://euclinicaltrials.eu/ctis-public/view/2024-518682-95-00